EU clinical trial 2026-525417-31-00: A randomised active-controlled trial to assess the safety and pharmacodynamics of two blinded doses of vortosiran and open-label apixaban in patients with non-valvular atrial fibrillation
Protocol code: RC03T002
Sponsor: Ribocure Pharmaceuticals AB (Pharmaceutical company). Phase: Therapeutic exploratory (Phase II). Countries: Norway (authorised, recruitment pending), Denmark (authorised, recruitment pending), Poland (authorised, recruitment pending), Sweden (authorised, recruitment pending).
Therapeutic area(s): Diseases [C] - Cardiovascular Diseases [C14]
Gender: Female, Male. Age: 18-64 years, 65+ years. Enrolment: 150.
Status: Authorised, recruitment pending. Decision date: 2026-07-24. Results received: No. Last updated: 2026-07-29.
Decision dates by country: DK: 2026-07-29, SE: 2026-07-24, NO: 2026-07-24, PL: 2026-07-29

Condition(s): non-valvular atrial fibrillation
Product: APIXABAN, RBD4059 injection, The corresponding placebo consist of the 25 mm phosphate buffer solution with 2 µg of vitamin b2 added for colouring purposes only

Primary endpoint: Percentage change in FXI activity from baseline at Week 16.
Endpoint(s): a) All bleeding events (including ISTH major, CRNM bleeding, and minor bleeding) during the treatment period., b) AEs (including intensity and seriousness) during the trial, as well as clinically significant changes in laboratory parameters and vital signs., c) Absolute and percentage change from baseline in FXI activity and FXI xx throughout the trial period, including intervals where subjects are receiving overlapping vortosiran and apixaban., d) Plasma concentrations of vortosiran summarised by sampling collection time points., e) Incidence of positive immunogenicity, measured as titre of ADAs, at each evaluation time point. (Only to be analysed if warranted based on emerging safety-, PK- or PD data), f) Change from baseline in APTT and PT/INR levels throughout the trial period., g) Absolute and percentage change xx.

Source: https://euclinicaltrials.eu/ctis-public/view/2026-525417-31-00